EU clinical trial 2024-514228-18-00: A Phase 2b, Randomised, Double-Blind, Placebo Controlled Dose Range Finding Study to Assess Efficacy and Safety of Multiple Dose Levels of Inhaled AZD8630 Given Once Daily for 12 Weeks in Adults with Uncontrolled Asthma at Risk of Exacerbations (LEVANTE).
Protocol code: D6830C00003
Sponsor: AstraZeneca AB (Pharmaceutical company). Phase: Therapeutic exploratory (Phase II). Countries: Germany (ended), Spain (ended), Italy (ended), Slovakia (ended), Netherlands (ended), Czechia (ended), France (ended), Denmark (ended), Belgium (ended).
Therapeutic area(s): Diseases [C] - Respiratory Tract Diseases [C08]
Gender: Female, Male. Age: 18-64 years, 65+ years. Enrolment: 110.
Status: Ended. Start date (EU): 2025-01-16. End date (EU): 2026-02-04. End date: 2026-02-05. Decision date: 2024-12-13. Results received: No. Last updated: 2026-07-01.
Decision dates by country: BE: 2024-12-13, CZ: 2024-12-18, DK: 2024-12-18, DE: 2024-12-17, NL: 2024-12-13, SK: 2024-12-13, IT: 2024-12-16, ES: 2024-12-16, FR: 2024-12-13

Condition(s): Asthma in adults who remain uncontrolled despite medium to high dose ICS plus LABA, and who are at risk of exacerbations.
Product: AZD8630, AZD8630, AZD8630 Placebo, AZD8630

Primary endpoint: Time to first CompEx Asthma event
Endpoint(s): To evaluate the effect of AZD8630 as compared to placebo on lung function: Change from baseline to: Measured in the clinic: 1 Pre-BD FEV1 2 Post-BD FEV1 3 Pre-BD FEF25-75 4 Pre-BD FVC 5 Post-BD FVC Measured in the home 6. PEF: Weeks 1, 2, 4, 6, 8, 7. maximum pre-BD, To evaluate the effect of AZD8630 as compared to placebo on asthma symptoms, asthma control and quality of life Change from baseline to: 1 Weekly mean asthma symptom diary score: 2 ACQ-6 3 AQLQ+12 4 SGRQ 5 SNOT-22 (for patients with chronic rhinosinusitis with nasal polyposis), To evaluate the effect of AZD8630 as compared with placebo on asthma-related biomarkers Change from baseline to: 1 FeNO 2 Blood eosinophils 3 Total IgE, To evaluate the pharmacokinetics (PK) of AZD8630 and ADA AZD8630 serum concentrations and ADA (incidence and titres).

Source: https://euclinicaltrials.eu/ctis-public/view/2024-514228-18-00